EU clinical trial 2024-511981-36-00: A Phase 1b/2a Open-label Single Ascending Doses (SAD) and Multiple Ascending Doses (MAD) Research Study to Evaluate Safety, Tolerability, Pharmacokinetics and Pharmacodynamics in Participants with AATD Pi*ZZ on WVE-006 (RestorAATion-2)
Protocol code: WVE-006-002
Sponsor: Wave Life Sciences Ireland Limited (Pharmaceutical company). Phase: Phase I and Phase II (Integrated)- Other. Countries: Finland (ongoing, recruitment ended), Germany (ongoing, recruitment ended).
Therapeutic area(s): Diseases [C] - Respiratory Tract Diseases [C08]; Diseases [C] - Digestive System Diseases [C06]; Diseases [C] - Congenital, Hereditary, and Neonatal Diseases and Abnormalities [C16]
Gender: Female, Male. Age: 18-64 years, 65+ years. Enrolment: 7.
Status: Ongoing, recruitment ended. Start date (EU): 2025-01-06. Decision date: 2024-12-03. Results received: No. Last updated: 2026-05-27.
Decision dates by country: DE: 2025-02-20, FI: 2024-12-03

Condition(s): Alpha-1 antitrypsin deficiency (AATD)
Product: WVE-006

Primary endpoint: The proportion of participants with adverse events.
Endpoint(s): Single Ascending Dose - Change from baseline in levels of serum M-AAT protein., Multiple Ascending Dose - Change from baseline in levels of serum M-AAT protein, Single Ascending Dose - Area under the plasma concentration time curve for WVE-006 from time of dosing to the last measurable concentration (AUClast), Single Ascending Dose - Maximum concentration of WVE-006 in plasma, Multiple Ascending Doses - Area under the plasma concentration time curve for WVE-006 from time of dosing to the last measurable concentration (AUClast), Multiple Ascending Doses - Maximum concentration of WVE-006 in plasma (Cmax)

Source: https://euclinicaltrials.eu/ctis-public/view/2024-511981-36-00